EU clinical trial 2024-512353-24-01: Induction of neo-antigen specific T cells by specialized cross-presenting dendritic cells in epithelial ovarian cancer patients treated with neoadjuvant chemotherapy, the NEODOC study
Sponsor: Stichting Radboud universitair medisch centrum (Hospital/Clinic/Other health care facility). Phase: Phase I and Phase II (Integrated)- First administration to humans. Countries: Netherlands (ended).
Therapeutic area(s): Diseases [C] - Neoplasms [C04]
Gender: Female. Age: 18-64 years, 65+ years. Enrolment: 10.
Status: Ended. End date (EU): 2025-12-31. Decision date: 2024-11-29. Results received: No. Last updated: 2025-12-08.

Condition(s): Ovarian cancer

Primary endpoint: The primary endpoint of the study is the immune response enhanced or induced by autologous tumor lysate-loaded XP-DC in epithelial ovarian cancer patients.

Source: https://euclinicaltrials.eu/ctis-public/view/2024-512353-24-01